EU clinical trial 2024-515461-34-00: A Study on Oral and Intranasal Forms in Healthy Volunteers using Pharmacokinetic Modeling
Sponsor: Consorci Mar Parc De Salut De Barcelona (Hospital/Clinic/Other health care facility). Phase: Human Pharmacology (Phase I)- Other. Countries: Spain (ended).
Therapeutic area(s): Not possible to specify
Gender: Female, Male. Age: 18-64 years. Enrolment: 8.
Status: Ended. Start date (EU): 2025-05-14. End date (EU): 2025-10-07. Decision date: 2025-04-15. Results received: No. Last updated: 2025-04-15.

Condition(s): healthy volunteers

Source: https://euclinicaltrials.eu/ctis-public/view/2024-515461-34-00